EU clinical trial 2023-503447-33-00: Pivmecillinam as oral step-down treatment for Escherichia coli febrile urinary tract infection versus standard of care; a randomized controlled non-inferiority multicenter trial
Protocol code: PIVOT
Sponsor: Uppsala Universitet (Educational Institution). Phase: Therapeutic exploratory (Phase II). Countries: Sweden (ongoing, recruiting), Norway (authorised, recruitment pending).
Therapeutic area(s): Diseases [C] - Bacterial Infections and Mycoses [C01]
Gender: Female, Male. Age: 18-64 years, 65+ years. Enrolment: 560.
Start date (EU): 2025-11-13. Decision date: 2025-10-06. Results received: No. Last updated: 2025-10-08.
Decision dates by country: SE: 2025-10-06, NO: 2025-10-08

Condition(s): febrile Urinary Tract Infection (fUTI)
Product: ERTAPENEM, AMIKACIN, CEFOTAXIME, IMIPENEM AND CILASTATIN, GENTAMICIN, CIPROFLOXACIN, MEROPENEM, CEFTRIAXONE, AMOXICILLIN, AMOXICILLIN AND BETA-LACTAMASE INHIBITOR, PIPERACILLIN AND BETA-LACTAMASE INHIBITOR, CEFUROXIME, SULFAMETHOXAZOLE AND TRIMETHOPRIM, TOBRAMYCIN, FOSFOMYCIN, AMPICILLIN, PIVMECILLINAM, AZTREONAM

Primary endpoint: Clinical response: i) no new healthcare contacts or antibiotic treatments for suspected or proven UTI, ii) sustained defervescence (< 38°C), and iii) patient-documented resolution of fUTI symptoms that were present and recorded in the eCRF at trial entry (and no new fUTI symptoms) at test of cure (TOC), which will be performed 7 (+/-2) days after EOT.
Endpoint(s): Sustained clinical response: i) no new healthcare contacts or antibiotic treatments for suspected or proven UTI, ii) no recurrent fever (≥ 38°C), and iii) no recurrent UTI symptoms after completion of the initial therapy and until 28 (+/- 2) days after EOT., Microbiological response: no detectable growth of E. coli in urine sampled at TOC, 7 (+/-2) days after EOT., Sustained microbiological response; no detectable growth of E. coli in urine sampled at the second follow-up 28 (+/- 2) days after EOT., Occurrence and severity of AEs from start of study treatment until TOC: recorded by the participating patients in a diary, documented in the medical records, or reported at the TOC follow-up., Disturbances in the intestinal microbiome: analysed by repeated collection of fecal samples from 30 patients treated with pivmecillinam or ciprofloxacin, respectively., Pharmacokinetics of mecillinam in plasma and urine and PK/PD target attainment; assessed by blood and urine sampling from 30 patients treated with pivmecillinam., Cost-effectiveness of pivmecillinam as compared with standard of care.

Source: https://euclinicaltrials.eu/ctis-public/view/2023-503447-33-00